EU clinical trial 2024-519087-41-00: A phase III study comparing the concurrent versus the sequential administration of chemotherapy and aromatase inhibitors, as adjuvant treatment of post-menopausal patients with endocrine-responsive early breast cancer
Protocol code: GIM10-CONSENT
Sponsor: IRCCS Ospedale Policlinico San Martino (Hospital/Clinic/Other health care facility). Phase: Therapeutic confirmatory (Phase III). Countries: Italy (ongoing, recruitment ended).
Therapeutic area(s): Diseases [C] - Neoplasms [C04]
Gender: Female. Age: 18-64 years, 65+ years. Enrolment: 1014.
Status: Ongoing, recruitment ended. Start date (EU): 2025-02-03. Decision date: 2025-02-03. Results received: No. Last updated: 2026-08-03.

Condition(s): Breast cancer is the most common form of cancer among women in North America, Europe and Latin America. Beacause nearly 80% of breast cancers are endocrine-responsive tumors, the majority of patients candidates for adjuvant chemotherapy (CT) are also candidates for endocrine therapy (ET).The optimal timing (i.e. concomitant vs sequential administration) for the integration of these two treatments has not been clearly defined yet.
Product: LETROZOLE, EXEMESTANE, ANASTROZOLE

Primary endpoint: According to the STEEP system (Hudis et al. J Clin Oncol 2007; 25:2127-2132) the primary endpoint will be the so called DFS, defined as time elapsing between the date of randomization and the date of one of the following events, whichever occurs first - Local Recurrence of disease - Regional recurrence of disease - Distant recurrence of disease - Contralateral invasive or intraductal breast cancer - Second primary malignancy other than breast - Death for any cause
Endpoint(s): the OS defined as time elapsing between the date of randomization and the date of death for any cause, all the other outcomes defined within the STEEP system, safety: clinical and laboratory toxicities will be graded according to NCI criteria CTCAE

Source: https://euclinicaltrials.eu/ctis-public/view/2024-519087-41-00